EU clinical trial 2025-521393-34-00: A research study looking at how NNC0487-0111 affects food intake, appetite and metabolism after meals in people with obesity
Protocol code: NN9490-8151
Sponsor: Novo Nordisk A/S (Pharmaceutical company). Phase: Human Pharmacology (Phase I)- Other. Countries: Germany (ongoing, recruiting).
Therapeutic area(s): Not possible to specify
Gender: Female, Male. Age: 18-64 years. Enrolment: 120.
Status: Ongoing, recruiting. Start date (EU): 2026-03-19. Decision date: 2026-03-13. Results received: No. Last updated: 2026-07-08.

Condition(s): Participants with obesity, but otherwise healthy

Source: https://euclinicaltrials.eu/ctis-public/view/2025-521393-34-00